EU clinical trial 2025-521697-34-00: A Phase 3, Double-Blind, Placebo-Controlled, Randomized Study to Assess the Safety of Epicutaneous Immunotherapy with DBV712 250 µg in 1-through 3-year-old Children with Peanut Allergy
Protocol code: V712-308
Sponsor: Dbv Technologies (Pharmaceutical company). Phase: Therapeutic confirmatory (Phase III). Countries: Spain (ongoing, recruitment ended), France (ongoing, recruitment ended), Netherlands (ongoing, recruitment ended), Ireland (ongoing, recruitment ended).
Therapeutic area(s): Diseases [C] - Immune System Diseases [C20]
Gender: Female, Male. Age: 0-17 years. Enrolment: 54.
Status: Ongoing, recruitment ended. Start date (EU): 2025-12-01. Decision date: 2025-10-20. Results received: No. Last updated: 2026-07-08.
Decision dates by country: IE: 2025-10-31, NL: 2025-10-29, ES: 2025-10-20, FR: 2025-10-20

Condition(s): Peanut allergy
Product: Peanut food challenge, oral paste “low dose” - 6.6 mg/g peanut proteins, ALK 762 Jordnød, Opløsning til priktest (Soluprick), Nøddeallergen, Peanut food challenge, oral paste “placebo” - Placebo formulation, Soluprick Positive control, 10 mg/ml, Solution for skin-prick test, Peanut food challenge, oral paste “high dose” - 133.3 mg/g peanut proteins, Viaskin Peanut, Soluprick Negative control, Solution for skin prick test, The DBV712 Placebo Patch is the same system as DBV712 250 mcg Patch but without peanut proteins

Primary endpoint: The following study drug safety criteria will be evaluated: • AEs and Treatment Emergent Adverse Events (TEAEs) by system organ class (SOC) and Preferred Term (PT), TEAEs by maximum severity, duration, and relatedness to treatment, TEAEs leading to discontinuation, Severity of local cutaneous DBV712 system induced AEs as assessed by the Investigator at study visits, AESI including local and systemic AESIs, Local AESIs: severe local site reactions (grade 4 with loss of skin barrier integrity), Systemic AESIs: systemic allergic reactions, including those leading to epinephrine use, whatever the causal relationship to DBV712 250 µg, AEs leading to epinephrine use, irrespective of the causal relationship to DBV712 250 µg, AEs leading to inhaled or systemic corticosteroid use, irrespective of the causal relationship to DBV712 250 µg, SAEs by SOC and PTs and SAEs relatedness to treatment, Laboratory data, physical examinations and vital signs, Assessment of pain and ease of removal of DBV712
Endpoint(s): The following exploratory assessments will be evaluated: • Change from baseline in peanut-specific IgE and IgG4, Change from baseline in peanut-component-specific IgE and IgG4, Change from baseline in peanut SPT mean wheal diameters, Description of reactions triggered by peanut consumption during the study, SCORAD evolution over time, Assessment of system adhesion and average daily application time, Parent/caregiver daily assessment of Local Skin Reactions (itching, redness and swelling)

Source: https://euclinicaltrials.eu/ctis-public/view/2025-521697-34-00